EU clinical trial 2022-502338-20-00: HU-F-AIM - A prospective, interventional study to evaluate HU-resistance in polycythemia vera patients who meet predictive parameters identified in the machine learning project PV-AIM
Protocol code: CINC424BDE15
Sponsor: Novartis Pharma GmbH (Pharmaceutical company). Phase: Therapeutic use (Phase IV). Countries: Germany (ended).
Therapeutic area(s): Diseases [C] - Neoplasms [C04]
Gender: Female, Male. Age: 18-64 years, 65+ years. Enrolment: 300.
Status: Ended. Start date (EU): 2023-07-28. End date (EU): 2026-02-26. Decision date: 2023-05-17. Results received: No. Last updated: 2025-09-11.

Condition(s): Polycythemia vera
Product: HYDROXYCARBAMIDE

Primary endpoint: Proportion of PV patients with HU-resistance/intolerance within 6-9 months after start of de novo HU- treatment in presence of the PV-AIM HU-resistance predictors at the start of HU treatment.
Endpoint(s): Proportion of PV patients who meet the PV-AIM HU-resistance predictors before start of HU-treatment, Proportion of patients developing HU resistance/intolerance at any time within the maximum treatment period of 15 months, Proportion of patients developing HU resistance/intolerance at any time within the maximum treatment period of 15 months in presence or absence of the PV-AIM HU-resistance predictors at start of HU treatment., For all patients who develop HU resistance/intolerance according to (European LeukemiaNet) ELN criteria at any time during the maximum treatment period of 15 months • Proportion of “non-switchers” (i.e., patients remaining on HU despite they meet the HU-resistance/intolerance criteria) compared to “switchers” • Timepoint of therapy switch (after confirmation of HU resistance/intolerance) • Reasons for therapy switch / non-switch • Therapies applied during follow-up period

Source: https://euclinicaltrials.eu/ctis-public/view/2022-502338-20-00